EU clinical trial 2024-514101-65-00: A Phase 2 Study of Teclistamab in Combination with Daratumumab or Lenalidomide in Elderly Patients with Newly Diagnosed Multiple Myeloma - IFM2021-01
Protocol code: 2022_0174
Sponsor: Centre Hospitalier Universitaire De Lille (Hospital/Clinic/Other health care facility). Phase: Therapeutic exploratory (Phase II). Countries: France (ongoing, recruitment ended).
Therapeutic area(s): Diseases [C] - Neoplasms [C04]
Gender: Female, Male. Age: 65+ years. Enrolment: 74.
Status: Ongoing, recruitment ended. Start date (EU): 2023-12-21. Decision date: 2024-07-19. Results received: No. Last updated: 2026-03-16.

Condition(s): Multiple Myeloma
Product: TECLISTAMAB, LENALIDOMIDE, DARATUMUMAB, TECLISTAMAB

Primary endpoint: Rate of very good partial response (VGPR) or better according to the IMWG criteria in patients with newly diagnosed multiple myeloma after 4 cycles of treatment with Tec-Dara or Tec-Len.
Endpoint(s): ORR, (PR or better) as defined by the IMWG response criteria after 2 cycles of treatment, Treatment-emergent adverse events as defined by the National Cancer Institute Common Terminology for Adverse Events (NCI CTCAE, version 5.0)., - ORR, (PR or better) as defined by the IMWG response criteria. - VGPR or better - Complete response (CR) or better - Time to Response - Duration of response (DOR) - Progression-free survival (PFS) - Overall survival (OS) - Time to treatment failure (time from date of inclusion to discontinuation of treatment for any reason, including death, progression, toxicity) - Time to Next Treatment (TTNT), - MRD negativity (at the 10-5 and 10-6 level by next generation sequencing [NGS]) at 6 months. - Sustained MRD negativity (at the 10-5 and 10-6 level by NGS) at 18 months (12 months after the initial MRD point).

Source: https://euclinicaltrials.eu/ctis-public/view/2024-514101-65-00